EU clinical trial 2025-520782-48-00: Therapheutic optimization of omalizumab in allergic severe asthma patients by dose and frequency of administration adjustment
Sponsor: Consorci Mar Parc De Salut De Barcelona (Hospital/Clinic/Other health care facility). Phase: Therapeutic use (Phase IV). Countries: Spain (authorised, recruitment pending).
Therapeutic area(s): Diseases [C] - Immune System Diseases [C20]; Diseases [C] - Respiratory Tract Diseases [C08]; Analytical, Diagnostic and Therapeutic Techniques and Equipment [E] - Therapeutics [E02]
Gender: Female, Male. Age: 18-64 years, 65+ years. Enrolment: 110.
Status: Authorised, recruitment pending. Decision date: 2025-01-30. Results received: No. Last updated: 2025-01-30.

Condition(s): Asthma
Product: Xolair 75 mg solution for injection in pre-filled syringe, Xolair 150 mg solution for injection in pre-filled syringe

Primary endpoint: The aim of this study is to value if a 50% omalizumab dose reduction in patients who suffer from allergic asthma, will allow to keep the same control of clinical stability. It is assessed by the lack of crisis, quality life and lung function.

Source: https://euclinicaltrials.eu/ctis-public/view/2025-520782-48-00